EU clinical trial 2024-511201-32-00: An Open-label, Extension Study to Assess the Long-Term Safety and Efficacy of ION-682884 in Patients with Hereditary Transthyretin-Mediated Amyloid Polyneuropathy
Protocol code: ION-682884-CS13
Sponsor: Ionis Pharmaceuticals Inc. (Pharmaceutical company). Phase: Therapeutic confirmatory (Phase III). Countries: Portugal (ongoing, recruiting), Sweden (ended), Cyprus (ended), Germany (ended), France (ongoing, recruiting), Spain (ended), Italy (ongoing, recruiting).
Therapeutic area(s): Diseases [C] - Congenital, Hereditary, and Neonatal Diseases and Abnormalities [C16]
Gender: Female, Male. Age: 18-64 years, 65+ years. Enrolment: 47.
Start date (EU): 2022-06-13. Decision date: 2024-08-08. Results received: No. Last updated: 2026-04-23.
Decision dates by country: FR: 2024-08-22, CY: 2024-08-08, ES: 2024-09-06, IT: 2024-09-24, DE: 2024-08-13, SE: 2024-08-08, PT: 2024-08-09

Condition(s): Hereditary Transthyretin-Mediated Amyloid Polyneuropathy
Product: ION 682884, ION 682884

Primary endpoint: The primary endpoints (PEP) are change from Baseline (Index Study Baseline and separately open-label extension [OLE] Baseline) in the following measures: • Platelet count, renal function and transaminases • Adverse events (AE) • Use of concomitant medications • Vital signs and weight • Physical examination findings • Clinical laboratory tests • Electrocardiogram (ECG) parameters, The primary endpoints (PEP) are change from Baseline (Index Study Baseline and separately open-label extension [OLE] Baseline) in the following measures: • Thyroid panel tests • Coagulation tests • Inflammatory panel tests • Complement and immunogenicity tests
Endpoint(s): The secondary endpoints are Change from Baseline (Index Study Baseline and separately OLE Baseline) in the following measures: • Neuropathy Impairment Score (NIS) • Norfolk Quality of Life-Diabetic Neuropathy (Norfolk QOL-DN) questionnaire, The secondary endpoints are Change from Baseline (Index Study Baseline and separately OLE Baseline) in the following measures: Neuropathy Symptom and Change score (NSC) • Serum Transthyretin (TTR) concentration • Physical Component Summary score (PCS) of 36-Item Short Form Survey (SF-36), The secondary endpoints are Change from Baseline (Index Study Baseline and separately OLE Baseline) in the following measures: • Polyneuropathy disability score (PND) • Modified body mass index (mBMI) • Composite Autonomic Symptom Score-31 (COMPASS-31) • 5 Level EQ-5D (EQ-5D-5L)

Source: https://euclinicaltrials.eu/ctis-public/view/2024-511201-32-00